EU clinical trial 2024-517672-38-00: Prophylactic treatment of breast implants with a solution of gentamicin, vancomycin and cefazolin antibiotics for women undergoing breast reconstructive surgery: a randomized controlled trial (The BREAST-AB trial)
Protocol code: BREAST-AB-01
Sponsor: Rigshospitalet (Hospital/Clinic/Other health care facility). Phase: Therapeutic confirmatory (Phase III). Countries: Denmark (ongoing, recruitment ended).
Therapeutic area(s): Diseases [C] - Bacterial Infections and Mycoses [C01]
Gender: Female. Age: 18-64 years, 65+ years. Enrolment: 1003.
Status: Ongoing, recruitment ended. Start date (EU): 2024-09-20. Decision date: 2024-09-20. Results received: No. Last updated: 2026-02-05.

Condition(s): Infection
Product: Natriumklorid Fresenius Kabi 9 mg/ml infusionsvätska, lösning, Cefazolin Hikma 2 g Pulver zur Herstellung einer Injektions-/Infusionslösung, SODIUM CHLORIDE, GENTAMICIN, CEFAZOLIN, VANCOMYCIN

Primary endpoint: All-cause explantation of the breast implant within 180 days after the breast reconstruction surgery
Endpoint(s): Time to explantation (days), All-cause explantation of the breast implant within 1 year after the breast reconstruction surgery (Y/N), Revision surgery with incision of the fibrous capsule within 180 days after the breast reconstruction surgery (Y/N), Exchange of permanent implant to expander implant within 180 days after the breast reconstruction surgery (Y/N), Surgical site infection that leads to antibiotic treatment within 180 days after the breast reconstruction surgery (Y/N), Infection-specific revision surgery: Revision surgery due to clinically suspected deep surgical site infection with surgical access to the breast implant pocket or clinical signs of an infection in the breast implant pocket found intraoperatively within 180 days after the breast reconstruction surgery (Y/N)

Source: https://euclinicaltrials.eu/ctis-public/view/2024-517672-38-00